EU clinical trial 2023-509265-21-00: A phase Ib/II randomized double-blind placebo controlled trial evaluating the effect of nivolumab for patients with in-transit melanoma metastases treated with isolated limb perfusion
Protocol code: the NivoILP trial
Sponsor: Vaestra Goetalandsregionen (Hospital/Clinic/Other health care facility). Phase: Therapeutic exploratory (Phase II). Countries: Sweden (ongoing, recruiting), Netherlands (ongoing, recruiting).
Therapeutic area(s): Diseases [C] - Neoplasms [C04]
Gender: Female, Male. Age: 18-64 years, 65+ years. Enrolment: 74.
Status: Ongoing, recruiting. Start date (EU): 2019-04-08. Decision date: 2024-02-19. Results received: No. Last updated: 2025-04-23.
Decision dates by country: SE: 2024-02-20, NL: 2024-02-19

Condition(s): In-transit metastasis of malignant melanoma
Product: SODIUM CHLORIDE, OPDIVO 10 mg/mL concentrate for solution for infusion.

Primary endpoint: CR rate at 3 months after ILP measured according to RECIST 1.1 criteria.
Endpoint(s): Time to local progression (TTLP), Distant metastases-free survival (DMFS), Progression-free survival (PFS), Overall survival (OS), Melanoma-specific survival (MSS), Adverse Events (AE) and Serious Adverse Events (SAE), QoL (FACT-M and EQ-5D), The quantitative and qualitative effects of ILP vs. ILP + nivolumab on immune cell phenotypes and function

Source: https://euclinicaltrials.eu/ctis-public/view/2023-509265-21-00